EU clinical trial 2022-501693-19-00: Transfer of metformin into human breast milk and the plasma of breastfeeding children - A low intervention trial with biobanking of breast milk and plasma in Västra Götalandsregionen and Region Örebro
Sponsor: Uppsala Universitet (Educational Institution). Phase: Therapeutic use (Phase IV). Countries: Sweden (ended).
Therapeutic area(s): Diseases [C] - Immune System Diseases [C20]
Gender: Female. Age: 0-17 years, 18-64 years. Enrolment: 30.
Status: Ended. Start date (EU): 2024-03-06. End date (EU): 2025-12-31. Decision date: 2024-01-23. Results received: No. Last updated: 2024-11-19.
Decision dates by country: SE: 2024-01-24

Condition(s): type 2 diabetes mellitus and gestational diabetes mellitus
Product: METFORMIN

Primary endpoint: The primary endpoint is the concentration of metformin in the breastfeeding child’s plasma 4h after maternal dose intake.
Endpoint(s): The secondary endpoint is the concentration of metformin in breast milk at 0h (through) and 3h after intake. The tertiary endpoint is the maternal plasma concentration of metformin at 0h (through), 2h and 3h after intake.

Source: https://euclinicaltrials.eu/ctis-public/view/2022-501693-19-00